EU clinical trial 2025-524834-24-00: IL-1β blockade to prevent Immunothrombosis in recipients of a Pancreatic Organ (ILIPO)
Protocol code: RC24-0546
Sponsor: Centre Hospitalier Universitaire De Nantes (Hospital/Clinic/Other health care facility). Phase: Phase I and Phase II (Integrated)- Other. Countries: France (authorised, recruitment pending).
Therapeutic area(s): Diseases [C] - Immune System Diseases [C20]
Gender: Female, Male. Age: 18-64 years, 65+ years. Enrolment: 15.
Status: Authorised, recruitment pending. Decision date: 2026-03-12. Results received: No. Last updated: 2026-08-06.

Condition(s): diabetic patients pancreatic transplant
Product: PROGRAF 1 mg capsule, Erelzi 25 mg solution for injection in pre-filled syringe., Kineret 100 mg/0.67 ml solution for injection in pre-filled syringe., Myfortic 360 mg gastrorezistentné tablety

Primary endpoint: The primary endpoint will be the type, severity, number (and percentage) of adverse events occurring in the first year after pancreatic transplantation, with a particular focus on severe infections (bacterial, viral, fungal or parasitic infections that are life-threatening and/or require hospitalisation), the occurrence of rejection proven by biopsy, and graft survival compared to a historical control cohort (DIVAT Nantes Cohort)
Endpoint(s): Patient survival will be determined by patients who are alive one year after pancreatic transplantation., Pancreatic graft failure is determined by the occurrence of one of the following criteria one year after transplantation: Need for daily insulin treatment and/or removal of the pancreatic graft (i.e., pancreas transplantectomy) and/or pancreatic retransplantation and/or islet cell transplantation., Evaluation of C-peptide, fasting blood glucose, insulin requirements and HbA1c one year after transplantation to calculate the β2 score and Igls criteria28,29. Evaluation of oral glucose tolerance test (OGTT) one year after transplantation., Assessment of creatinine levels, estimated glomerular filtration rate (CKD-EPI formula) and proteinuria one year after simultaneous kidney-pancreas transplantation., Occurrence of severe bacterial infectious complications, i.e. requiring hospitalisation., Occurrence of CMV viraemia, asymptomatic and/or associated with CMV disease (i.e. organ damage related to CMV replication: haematological, digestive, hepatic or pulmonary)., Occurrence of BK virus viremia, asymptomatic and/or associated with BK virus nephropathy confirmed by biopsy., Occurrence of a proven fungal infection., Occurrence of pancreatic rejection defined by pancreatic biopsy (according to Banff criteria) and/or renal biopsy in the presence of evidence of associated pancreatic rejection (i.e., lipasaemia > 3 times normal + unexplained inflammatory syndrome + unexplained hyperglycaemia)., Occurrence of renal graft rejection confirmed by renal biopsy (according to Banff criteria)., Occurrence of graft-directed antibodies at one year, considered significant with a Mean Fluorescence Index (MFI) > 500.

Source: https://euclinicaltrials.eu/ctis-public/view/2025-524834-24-00